EU clinical trial 2023-504178-39-00: Local tolerance and PK/PD assessment of TAR-0520 gel when applied topically in healthy subjects
Protocol code: TAR006
Sponsor: TARIAN PHARMA (SME). Phase: Human Pharmacology (Phase I)- Other. Countries: France (ongoing, recruitment ended).
Therapeutic area(s): Diseases [C] - Skin and Connective Tissue Diseases [C17]
Gender: Female, Male. Age: 18-64 years. Enrolment: 36.
Status: Ongoing, recruitment ended. Start date (EU): 2023-11-09. Decision date: 2023-10-23. Results received: No. Last updated: 2023-10-23.

Condition(s): Prevention of anticancer therapy adverse reactions

Source: https://euclinicaltrials.eu/ctis-public/view/2023-504178-39-00